EU clinical trial 2023-508163-74-00: An Open-label, Long-term, Safety and Efficacy Study of Aticaprant as Adjunctive Therapy in Adult and Elderly Participants With Major Depressive Disorder (MDD)
Protocol code: 67953964MDD3003
Sponsor: Janssen Cilag International (Pharmaceutical company). Phase: Therapeutic confirmatory (Phase III). Countries: Sweden (ended), Hungary (ended), France (ended), Portugal (ended), Slovakia (ended), Poland (ended), Italy (ended), Bulgaria (ended), Belgium (ended), Czechia (ended), Spain (ended).
Therapeutic area(s): Psychiatry and Psychology [F] - Mental Disorders [F03]
Gender: Female, Male. Age: 18-64 years, 65+ years. Enrolment: 356.
Status: Ended. Start date (EU): 2023-06-12. End date (EU): 2025-02-28. End date: 2025-05-08. Decision date: 2024-10-03. Results received: Yes. Last updated: 2024-11-11.
Decision dates by country: BE: 2024-10-03, BG: 2024-10-04, CZ: 2024-10-08, FR: 2024-10-11, HU: 2024-10-04, IT: 2024-10-28, PT: 2024-10-07, ES: 2024-10-08, SE: 2024-10-04, PL: 2024-11-11, SK: 2024-10-04

Condition(s): Major Depressive Disorder
Product: JNJ-67953964

Primary endpoint: AEs including AEs of special interest (AESI), Change from baseline in vital signs, Weight/body mass index (BMI), Suicidality assessment using the Columbia Suicidality Severity Rating Scale (C-SSRS), Laboratory parameters, 12-lead ECG, Assessment of withdrawal symptoms using the Physician Withdrawal Checklist, 20-item (PWC-20)., Proportion of participants with clinically relevant sexual dysfunction over time in the Arizona Sexual Experiences Scale (ASEX) score.

Source: https://euclinicaltrials.eu/ctis-public/view/2023-508163-74-00